EU clinical trial 2022-500308-23-00: A randomised, controlled, assessor-blind, parallel groups, multicentre, multinational trial comparing the ovarian response after controlled ovarian stimulation with mixed protocols of follitropin delta (REKOVELLE) and highly purified human menopausal gonadotropin (MENOPUR) in women undergoing an assisted reproductive technology programme
Sponsor: Ferring Pharmaceuticals A/S (Pharmaceutical company). Phase: Phase III and phase IV (Integrated). Countries: Italy (ended), Spain (ended).
Therapeutic area(s): Diseases [C] - Female Urogenital Diseases and Pregnancy Complications [C13]
Gender: Female. Age: 18-64 years. Enrolment: 115.
Decision date: 2022-11-08. Results received: No. Last updated: 2022-11-09.
Decision dates by country: IT: 2022-11-09, ES: 2022-11-08

Condition(s): Infertility in women undergoing assisted reproductive technologies (ART) such as an in vitro fertilisation (IVF) or intracytoplasmic sperm injection (ICSI) cycle
Product: Fyremadel, 0,25 mg/0,5 ml oplossing voor injectie in voorgevulde spuit, Decapeptyl 0,1 mg/1 ml, oplossing voor injectie, Menopur, Ovitrelle 250 micrograms/0.5 mL solution for injection in pre-filled syringe, REKOVELLE 72 micrograms/2.16 mL solution for injection in a pre-filled pen, Menopur, Ovitrelle 250 micrograms solution for injection in pre-filled pen

Primary endpoint: Number of fertilised (2 pronuclei [2PN]) oocytes at 19±2 hours after insemination

Source: https://euclinicaltrials.eu/ctis-public/view/2022-500308-23-00